EU clinical trial 2023-509316-28-00: Safety and tolerability of single and multiple ascending doses of lunsekimig (SAR443765) in healthy participants
Protocol code: SAD18184/MAD18185
Sponsor: Sanofi-Aventis Recherche & Developpement (Pharmaceutical company). Phase: Human Pharmacology (Phase I)- Other. Countries: Belgium (ended).
Therapeutic area(s): Diseases [C] - Respiratory Tract Diseases [C08]
Gender: Female, Male. Age: 18-64 years. Enrolment: 128.
Status: Ended. Start date (EU): 2024-05-06. End date (EU): 2024-12-24. Decision date: 2024-04-18. Results received: No. Last updated: 2025-01-07.

Condition(s): Asthma

Source: https://euclinicaltrials.eu/ctis-public/view/2023-509316-28-00